EU clinical trial 2024-514834-19-00: Vitamin D Supplementation to increase free testosterone in Type 2 Diabetes Mellitus men: a Placebo-controlled Randomized Clinical Trial
Sponsor: UZ Brussel (Hospital/Clinic/Other health care facility). Phase: Therapeutic exploratory (Phase II). Countries: Belgium (ongoing, recruiting).
Therapeutic area(s): Diseases [C] - Nutritional and Metabolic Diseases [C18]
Gender: Male. Age: 18-64 years, 65+ years. Enrolment: 100.
Status: Ongoing, recruiting. Start date (EU): 2018-12-05. Decision date: 2024-09-23. Results received: No. Last updated: 2024-09-23.

Condition(s): Type 2 Diabetes Mellitus
Product: D-Cure 25.000 U.I., solution buvable

Primary endpoint: The (change) in free testosteron concentration after 10 days and 3 months.

Source: https://euclinicaltrials.eu/ctis-public/view/2024-514834-19-00